EU clinical trial 2024-514758-65-00: A two-part, open-label, clinical study to assess the safety, tolerability and activity of intravenous doses of ICT01 in combination with low-dose subcutaneous interleukin-2 in patients with advanced solid tumors (EVICTION-2)
Protocol code: EVICTION-2
Sponsor: Imcheck Therapeutics (Pharmaceutical company). Phase: Phase I and Phase II (Integrated)- First administration to humans. Countries: France (ended), Germany (ended).
Therapeutic area(s): Diseases [C] - Neoplasms [C04]
Gender: Female, Male. Age: 18-64 years, 65+ years. Enrolment: 59.
Status: Ended. Start date (EU): 2022-05-04. End date (EU): 2025-10-09. End date: 2025-10-10. Decision date: 2024-07-12. Results received: No. Last updated: 2025-05-20.
Decision dates by country: FR: 2024-07-12, DE: 2024-07-15

Condition(s): metastatic castration-resistant prostate cancer (mCRPC), metastatic colorectal cancer (CRC), metastatic pancreatic ductal adenocarcinoma (PDAC), Metastatic or unresectable refractory melanoma, metastatic ovarian cancer
Product: KEYTRUDA 25 mg/mL concentrate for solution for infusion, PROLEUKIN® 18 x 106 IU Powder for solution for injection or infusion

Primary endpoint: Part 1. The primary objective of safety and tolerability will be evaluated in this study by the incidence, severity, and relationship of the following endpoints during the study: DLTs, TEAEs, fatal TEAEs, TESAEs, TEAEs leading to discontinuation of study treatment or treatment modifications; and incidence and severity of clinically significant findings on clinical laboratory tests, vital signs, ECGs, and physical examinations (Key secondary endpoint in Part 2)., Part 2. Disease control rate (DCR) comprising patients with stable disease, partial response, or complete response per RECIST.
Endpoint(s): In Part 1 the preliminary anti-tumor activity endpoint will be the DCR as per RECIST. If appropriate, objective response rate (ORR; the sum of CR + PR), time-to-progression (TTP), progression-free survival (PFS) and overall survival (OS) will also be analyzed as endpoints. The iRECIST will be considered exploratory and used for treatment decisions., In Part 2, key secondary endpoints include the safety and tolerability (same endpoints as for Part 1).

Source: https://euclinicaltrials.eu/ctis-public/view/2024-514758-65-00